EU clinical trial 2024-516446-18-00: Study to look at the safety, tolerability, and how the body processes the study medicine WAL0623 after single or repeated doses, with or without food, in healthy volunteers
Protocol code: WAL0623-01
Sponsor: Walden Biosciences Inc. (Pharmaceutical company). Phase: Human Pharmacology (Phase I)- First administration to humans. Countries: Italy (authorised, recruitment pending).
Therapeutic area(s): Diseases [C] - Male Urogenital Diseases [C12]
Gender: Female, Male. Age: 18-64 years. Enrolment: 84.
Status: Authorised, recruitment pending. Decision date: 2026-01-27. Results received: No. Last updated: 2026-01-27.

Condition(s): Glomerular kidney diseases with proteinuria

Source: https://euclinicaltrials.eu/ctis-public/view/2024-516446-18-00